EU clinical trial 2023-510357-42-00: A phase III, multicenter, randomized, open-label trial to evaluate efficacy and safety of ribociclib with endocrine therapy as an adjuvant treatment in patients with hormone receptor-positive, HER2-negative, early breast cancer (New Adjuvant TriAl with Ribociclib [LEE011]: NATALEE)
Protocol code: CLEE011O12301C
Sponsor: Novartis Pharma AG (Pharmaceutical company). Phase: Therapeutic confirmatory (Phase III). Countries: Hungary (ongoing, recruitment ended), Belgium (ongoing, recruitment ended), Spain (ongoing, recruitment ended), Ireland (ongoing, recruitment ended), Poland (ongoing, recruitment ended), France (ongoing, recruitment ended), Austria (ongoing, recruitment ended), Romania (ongoing, recruitment ended), Italy (ongoing, recruitment ended), Germany (ongoing, recruitment ended).
Therapeutic area(s): Diseases [C] - Neoplasms [C04]
Gender: Female, Male. Age: 18-64 years, 65+ years. Enrolment: 2394.
Status: Ongoing, recruitment ended. Start date (EU): 2019-05-22. Decision date: 2024-07-15. Results received: No. Last updated: 2026-08-07.
Decision dates by country: RO: 2024-07-17, AT: 2024-07-22, PL: 2024-07-22, IT: 2024-07-22, HU: 2024-07-19, IE: 2024-07-15, BE: 2024-07-16, FR: 2024-07-18, DE: 2024-07-22, ES: 2024-07-15

Condition(s): hormone receptor (HR)-positive, HER2-negative, early breast cancer (EBC).
Product: ANASTROZOLE, GOSERELIN, RIBOCICLIB, LETROZOLE

Primary endpoint: iDFS using STEEP criteria, as assessed by Investigator
Endpoint(s): RFS using STEEP criteria, DDFS using STEEP criteria, OS defined as time from date of randomization to date of death due to any cause, Change from baseline in the physical functioning sub-scale score and global health status/ QoL scale score as assessed by EORTC QLQ-C30, Frequency and severity of AEs, laboratory and Electrocardiogram (ECG) abnormalities, PK parameters such as Ctrough and other applicable parameters for ribociclib

Source: https://euclinicaltrials.eu/ctis-public/view/2023-510357-42-00